EU clinical trial 2022-501766-22-01: A study to test how well different doses of BI 764532 are tolerated by people with a tumour in the brain that is positive for DLL3
Protocol code: 1438-0003
Sponsor: Boehringer Ingelheim International GmbH, Boehringer Ingelheim Espana S.A., Boehringer Ingelheim RCV GmbH & Co. KG (Pharmaceutical company). Phase: Human Pharmacology (Phase I)- Other. Countries: Germany (ended), Netherlands (ongoing, recruitment ended), Spain (ongoing, recruitment ended), Austria (ongoing, recruitment ended).
Therapeutic area(s): Diseases [C] - Neoplasms [C04]
Gender: Female, Male. Age: 18-64 years, 65+ years. Enrolment: 14.
Start date (EU): 2024-04-23. Decision date: 2024-04-16. Results received: No. Last updated: 2026-03-02.
Decision dates by country: ES: 2024-04-16, AT: 2024-04-17, DE: 2024-04-16, NL: 2024-04-16

Condition(s): Glioma expressing DLL3

Source: https://euclinicaltrials.eu/ctis-public/view/2022-501766-22-01